EU clinical trial 2024-520156-22-00: A Phase II, randomized, open-label, multi-center study of JSB462 (luxdegalutamide) in combination with abiraterone in adult male patients with metastatic hormone-sensitive prostate cancer (mHSPC)
Protocol code: CJSB462C12201
Sponsor: Novartis Pharma AG (Pharmaceutical company). Phase: Therapeutic exploratory (Phase II). Countries: Italy (ongoing, recruitment ended), Poland (ongoing, recruitment ended), Spain (ongoing, recruitment ended), France (ongoing, recruitment ended), Czechia (ongoing, recruitment ended), Netherlands (ongoing, recruiting), Germany (ongoing, recruitment ended).
Therapeutic area(s): Diseases [C] - Neoplasms [C04]
Gender: Male. Age: 18-64 years, 65+ years. Enrolment: 63.
Start date (EU): 2025-10-08. Decision date: 2025-08-19. Results received: No. Last updated: 2026-05-04.
Decision dates by country: NL: 2025-08-19, CZ: 2025-10-20, DE: 2025-08-20, IT: 2025-08-19, PL: 2025-09-01, ES: 2025-08-22, FR: 2025-11-19

Condition(s): Metastatic hormone-sensitive prostate cancer
Product: DEGARELIX, RELUGOLIX, ABIRATERONE, DEGARELIX, Luxdegalutamide, ABIRATERONE, ABIRATERONE, Abiraterone, ENZALUTAMIDE, ABIRATERONE, Enzalutamide

Primary endpoint: PSA90 rate defined as the proportion of participants who achieve a ≥90% decrease in PSA from baseline at any timepoint, confirmed by a second PSA measurement ≥3 weeks without any PSA progression in between., Type, frequency and severity of AEs per CTCAE version 5.0 and changes in laboratory values, vital signs, and ECGs, Tolerability: dose interruptions, dose reductions, drug discontinuations, dose intensity, and duration of exposure to study treatment (all study drugs)
Endpoint(s): rPFS defined as time between randomization and the first occurrence of disease progression (per PCWG3-modified RECIST 1.1 as assessed by the investigator) or death due to any cause, OS defined as time between randomization and death due to any cause, Type, frequency and severity of xxxx AEs and changes in laboratory values (xxxx) as characterized by type, frequency, severity (as graded by NCI CTCAE version 5.0), ORR defined as proportion of participants achieving a confirmed complete response (CR) or partial response (PR) per PCWG3-modified RECIST 1.1 as assessed by the investigator, DCR defined as proportion of participants achieving a CR, PR or stable disease (SD) per PCWG3-modified RECIST 1.1 as assessed by the investigator, DOR defined as time between first documented CR/PR and disease progression or death due to any cause per PCWG3-modified RECIST 1.1 as assessed by the investigator, TTR defined as the time from randomization to the date of first documented CR or PR per PCWG3-modified RECIST 1.1 as assessed by the investigator, TTSTP defined as time from randomization to the date of first documented radiographic soft tissue progression per PCWG3-modified RECIST 1.1 as assessed by the investigator, PSA30 rate defined as the proportion of participants who achieve a ≥30% decrease from baseline at any timepoint, confirmed by a second PSA measurement ≥3 weeks without any PSA progression in between, PSA50 rate defined as the proportion of participants who achieve a ≥50% decrease from baseline at any timepoint, confirmed by a second PSA measurement ≥3 weeks without any PSA progression in between, PSA0, defined as the proportion of participants who achieve a PSA level <0.2 ng/ml at any timepoint after start of treatment, confirmed by a second PSA measurement ≥3 weeks without any PSA progression in between, Duration of biochemical response defined as time between PSA90 and/or PSA0 and PSA progression (increase ≥25% in PSA and an absolute increase of ≥2 ng/mL from NADIR) or death due to any cause, TTSSE defined as date of randomization to the date of first new symptomatic pathological bone fracture, spinal cord compression, tumor-related orthopedic surgical intervention, requirement for radiation therapy to relieve bone pain or death from any cause, whichever occurs first, Plasma concentrations of JSB462 and ARV-767 pre and post dose, Frequency, severity, and/or interference of selected items as assessed using the PRO-CTCAE

Source: https://euclinicaltrials.eu/ctis-public/view/2024-520156-22-00